EU clinical trial 2025-521614-26-00: A Study to Investigate the Pharmacokinetics and Safety of Subcutaneous Rilvegostomig in Adult Participants with Advanced Solid Tumors Previously Treated with Standard of Care Therapy
Protocol code: D702EC00001
Sponsor: AstraZeneca AB (Pharmaceutical company). Phase: Human Pharmacology (Phase I)- Other. Countries: Spain (ongoing, recruiting).
Therapeutic area(s): Diseases [C] - Neoplasms [C04]
Gender: Female, Male. Age: 18-64 years, 65+ years. Enrolment: 13.
Status: Ongoing, recruiting. Start date (EU): 2026-02-26. Decision date: 2026-01-15. Results received: No. Last updated: 2026-03-30.

Condition(s): Advanced Solid Tumors

Source: https://euclinicaltrials.eu/ctis-public/view/2025-521614-26-00